EU clinical trial 2023-506224-87-00: A Phase IIa randomized, controlled, open-label clinical trial to assess the efficacy, safety, and tolerability of the investigational medicinal product MBK-01, FSPIM (Full Spectrum & Purified Intestinal Microbiota) oral capsules, as well as to determine the optimal dosage in the treatment of patients with recurrent diverticulitis (DIREBIOT).
Protocol code: DIREBIOT
Sponsor: Mikrobiomik Healthcare Company S.L. (Pharmaceutical company). Phase: Therapeutic exploratory (Phase II). Countries: Spain (ongoing, recruiting).
Therapeutic area(s): Diseases [C] - Digestive System Diseases [C06]
Gender: Female, Male. Age: 18-64 years, 65+ years. Enrolment: 81.
Status: Ongoing, recruiting. Start date (EU): 2024-10-14. Decision date: 2024-01-10. Results received: No. Last updated: 2024-10-14.

Condition(s): Recurring diverticulitis
Product: Lyophilized capsules of fecal microbiota, METRONIDAZOLE, FOSFOMYCIN, AMOXICILLIN

Primary endpoint: Number of new episodes of acute diverticulitis during the trial., Occurrence of adverse events (AEs), serious AEs (SAEs), AEs resulting in discontinuation of study treatment, AEs of special interest (AESI), diverticulitis-related AEs, and changes in vital signs and laboratory values during the clinical trial., Number of new episodes of acute diverticulitis in the trial between the two MBK-01 regimens., Occurrence of treatment-related adverse events between the two MBK-01 regimens during the trial.
Endpoint(s): Time to first episode of acute diverticulitis., Time to successive episodes of acute diverticulitis (other than the first episode., Time to successive episodes of acute diverticulitis (other than the first episode., Number of hospitalizations due to acute diverticulitis in the trial., Number of courses of systemic antibiotic treatments used in the trial for episodes of acute diverticulitis., Need for surgery for acute diverticulitis during the trial., Changes in the Gastrointestinal Quality of Life Index (GIQLI) questionnaire., Changes in the SF-36 questionnaire.

Source: https://euclinicaltrials.eu/ctis-public/view/2023-506224-87-00